EU clinical trial 2025-520882-37-00: A Double-blind, Placebo-controlled, Single and Multiple Ascending Dose Phase 1 Study of CMP-CPS-001 in Healthy Volunteers and Participants with Abnormal Heterozygous Ornithine Transcarbamylase (OTC) Genotype
Protocol code: CPS-101
Sponsor: Camp4 Therapeutics Corp. (Pharmaceutical company). Phase: Human Pharmacology (Phase I)- First administration to humans. Countries: Netherlands (authorised, recruitment pending).
Therapeutic area(s): Diseases [C] - Congenital, Hereditary, and Neonatal Diseases and Abnormalities [C16]; Diseases [C] - Nutritional and Metabolic Diseases [C18]
Gender: Female, Male. Age: 0-17 years, 18-64 years. Enrolment: 12.
Status: Authorised, recruitment pending. Decision date: 2025-08-09. Results received: No. Last updated: 2025-08-09.

Condition(s): Urea cycle disorders (UCD)
Product: 15NH4Cl, Sodium Chloride for injection, [13C]Sodium Acetate, CMP-CPS-001

Primary endpoint: 1. Incidence of AEs, 2. Vital signs, 3. ECG, 4. Clinical laboratory assessment, 5. Physical examination
Endpoint(s): 1. Plasma concentration of CO-5122, the active ingredient of CMP-CPS-001, 2. Calculated PK parameters, 3. Urine concentration of CO-5122, the active ingredient of CMP-CPS-001, 4. Ureagenesis rate test determinations

Source: https://euclinicaltrials.eu/ctis-public/view/2025-520882-37-00